EU clinical trial 2025-521757-16-00: An Open-Label Study to Assess the Long-Term Safety and Tolerability of ML-007C-MA in Adult Participants with Hallucinations and Delusions Associated with Alzheimer’s Disease Psychosis
Protocol code: ML-007C-MA-222
Sponsor: Maplight Therapeutics Inc. (Pharmaceutical company). Phase: Therapeutic exploratory (Phase II). Countries: Italy (authorised, recruitment pending), Poland (authorised, recruitment pending), Czechia (authorised, recruitment pending), Portugal (authorised, recruitment pending), Bulgaria (ongoing, recruiting), France (ongoing, recruiting), Slovakia (authorised, recruitment pending), Romania (authorised, recruitment pending), Hungary (authorised, recruitment pending).
Therapeutic area(s): Psychiatry and Psychology [F] - Mental Disorders [F03]
Gender: Female, Male. Age: 18-64 years, 65+ years. Enrolment: 85.
Start date (EU): 2026-07-03. Decision date: 2026-05-27. Results received: No. Last updated: 2026-06-02.
Decision dates by country: BG: 2026-05-28, CZ: 2026-05-28, FR: 2026-05-28, HU: 2026-05-29, IT: 2026-05-29, PT: 2026-06-01, RO: 2026-06-02, PL: 2026-05-29, SK: 2026-05-27

Condition(s): Hallucinations and Delusions Associated with Alzheimer’s Disease Psychosis

Primary endpoint: Incidence of TEAEs, treatment-emergent SAEs, and TEAEs leading to study discontinuation
Endpoint(s): Safety: • Observed values and changes from OL Baseline in clinical safety laboratory assessments, 12-lead ECG parameters, vital sign parameters, and body weight • GCAS score • Changes from OL Baseline in ESRS-A score • Changes from OL Baseline in MMSE score, Effectiveness: Changes from OL Baseline in the following: • NPI-C H+D score • CGI-S hallucinations and delusions domain-specific score • NPI-C A+A score in participants who had a CGI-S agitation and aggression domain-specific score of ≥4 at OL Baseline • ADCS-ADL total score, Effectiveness: Changes from OL Baseline in ZBI-12 score, Pharmacokinetic: Plasma concentrations of ML-007 (and its major metabolites, if applicable)

Source: https://euclinicaltrials.eu/ctis-public/view/2025-521757-16-00